EU clinical trial 2024-517260-39-00: Investigating How Anti-Infection Drugs Are Processed in the Bodies of Healthy People and Severely Burned Patients in the Intensive Care Unit
Sponsor: Medical University Of Vienna (Educational Institution). Phase: Human Pharmacology (Phase I)- Other. Countries: Austria (ongoing, recruiting).
Therapeutic area(s): Diseases [C] - Skin and Connective Tissue Diseases [C17]; Diseases [C] - Pathological Conditions, Signs and Symptoms [C23]; Diseases [C] - Bacterial Infections and Mycoses [C01]
Gender: Female, Male. Age: 18-64 years, 65+ years. Enrolment: 82.
Status: Ongoing, recruiting. Start date (EU): 2017-09-15. Decision date: 2024-10-14. Results received: No. Last updated: 2024-10-14.

Condition(s): Combustion

Source: https://euclinicaltrials.eu/ctis-public/view/2024-517260-39-00